EU clinical trial 2023-508756-19-00: Pembrolizumab plus autologous dendritic cell vaccine in patients with advanced mesothelioma who have failed prior therapies
Protocol code: IRST100.39
Sponsor: Istituto Romagnolo Per Lo Studio Dei Tumori Dino Amadori IRST S.r.l. (Hospital/Clinic/Other health care facility). Phase: Human Pharmacology (Phase I)- Other. Countries: Italy (ended).
Therapeutic area(s): Diseases [C] - Neoplasms [C04]
Gender: Female, Male. Age: 18-64 years, 65+ years. Enrolment: 18.
Status: Ended. Start date (EU): 2019-10-29. End date (EU): 2025-10-24. Decision date: 2024-08-05. Results received: No. Last updated: 2025-10-14.

Condition(s): Mesothelioma

Source: https://euclinicaltrials.eu/ctis-public/view/2023-508756-19-00